EU clinical trial 2026-525620-23-00: Local and systemic immune modulation by Rilvegostomig (AZD2936) in the treatment of advanced gastric cancer (RILVE Project)
Protocol code: VHIO26001/ESR2523009
Sponsor: Vall D Hebron Institute Of Oncology (Laboratory/Research/Testing facility). Phase: Therapeutic exploratory (Phase II). Countries: Spain (authorised, recruitment pending).
Therapeutic area(s): Diseases [C] - Digestive System Diseases [C06]; Diseases [C] - Neoplasms [C04]
Gender: Female, Male. Age: 18-64 years, 65+ years. Enrolment: 38.
Status: Authorised, recruitment pending. Decision date: 2026-07-22. Results received: No. Last updated: 2026-07-28.

Condition(s): advanced gastric cancer
Product: Rilvegostomig, KEYTRUDA 25 mg/mL concentrate for solution for infusion.

Primary endpoint: Change from baseline to post–window-of-opportunity biopsy in predefined tumor and peripheral immune biomarkers reflecting immune cell infiltration, activation, and functional modulation induced by rilvegostomig in patients with treatment-naïve, advanced gastric cancer (GC).
Endpoint(s): Progression-free survival (PFS). PFS is defined as the time from randomization until radiological progression (per Response Evaluation Criteria in Solid Tumors, Version 1.1 [RECIST 1.1]) or death due to any cause (in the absence of progression)., Overall response rate (ORR). ORR is defined as the proportion of patients who have a confirmed complete response (CR) or confirmed partial response (PR), by using Response Evaluation Criteria in Solid Tumors, Version 1.1 (RECIST 1.1)., Presence of, or changes in phenotype or expression of immune and tumor marker/profile (activated T cells, immune cell receptor repertoires, HLA allotypes, IFN-γ, CD8, etc)., Presence/profile of, or changes in ctDNA mutation(s)/genomic alteration(s), and tumor mutation burden, from plasma and tumor samples., Biomarker expression and/or spatial distribution in the tumor microenvironment (eg, CD8, PD-L1, etc.) as measured by IHC and other assays including analytical methods (eg, digital pathology artificial intelligence)., Incidence and severity of adverse events (AEs) and serious adverse events (SAEs) graded according to the National Cancer Institute Common Terminology Criteria for Adverse Events (NCI CTCA) v 5., Changes in vital signs, physical findings, and clinical laboratory results., Adverse events leading to study drug discontinuation., Immune-mediated adverse events and dose-limiting toxicities

Source: https://euclinicaltrials.eu/ctis-public/view/2026-525620-23-00